EU clinical trial 2025-522790-10-00: IFCT-2502 LIMPID Phase II trial assessing 1st line and 2nd line treatment in patients with advanced Non-Small Cell Lung Cancer and Interstitial Lung Disease
Protocol code: IFCT-2502
Sponsor: Intergroupe Francophone De Cancerologie Thoracique (Patient organisation/association). Phase: Therapeutic exploratory (Phase II). Countries: France (authorised, recruitment pending).
Therapeutic area(s): Diseases [C] - Neoplasms [C04]
Gender: Female, Male. Age: 18-64 years, 65+ years. Enrolment: 108.
Status: Authorised, recruitment pending. Decision date: 2026-04-17. Results received: No. Last updated: 2026-04-17.

Condition(s): Non Small Cell Lung Cancer, Interstitial Lung Disease
Product: BEVACIZUMAB, PEMBROLIZUMAB, VINORELBINE, GEMCITABINE, NIVOLUMAB, PEMETREXED, PACLITAXEL, CARBOPLATIN

Primary endpoint: 1rst line : The primary endpoint is Disease control rate define by the % of patient with a stable (SD), partial response (PR) or complete response (CR) on CT scanner evaluation at 8 weeks assessed by investigators according to RECIST 1.1., 2nd line : The primary outcome is the treatment related respiratory worsening leading to discontinuation of treatment during the first 6 months
Endpoint(s): Progression-free survival, Duration of response, Overall survival, Best Overall Response, DCR at 8 weeks assessed by Independent Central Review (1st line part) and by investigators according to RECIST 1.1 (2nd line part), PFS, duration of response, OS, overall response rate (ORR) according to ILDs pattern on CT scan (centralized review) and severity (VC/DLCO)., Efficacy (PFS, duration of response, OS and Best Overall Response) and respiratory evolution (number of exacerbations of ILD) with or without anti-fibrosing treatment., Overall health status assessed using the FACT-L questionnaire, Incidence, nature, and severity of adverse events, graded according to the National Cancer Institute Common Terminology Criteria for Adverse Events, Version 6.0, 2nd line: Incidence, nature, and severity of immune related adverse events, graded according to the National Cancer Institute Common Terminology Criteria for Adverse Events, Version 5.0 (NCI CTCAE v6.0).

Source: https://euclinicaltrials.eu/ctis-public/view/2025-522790-10-00